EU clinical trial 2024-516299-13-00: Perioperative Treatment in Resectable Gastric Cancer with Spartalizumab (PDR001) in Combination with fluorouracil, leucovorin, oxaliplatin, and docetaxel (FLOT): A phase II study (GASPAR)
Protocol code: GASPAR
Sponsor: Centre Francois Baclesse (Hospital/Clinic/Other health care facility). Phase: Therapeutic exploratory (Phase II). Countries: France (ended).
Therapeutic area(s): Diseases [C] - Digestive System Diseases [C06]; Diseases [C] - Neoplasms [C04]
Gender: Female, Male. Age: 18-64 years, 65+ years. Enrolment: 68.
Status: Ended. Start date (EU): 2024-09-06. End date (EU): 2025-11-27. Decision date: 2024-09-05. Results received: Yes. Last updated: 2024-09-05.

Condition(s): Resectable Gastric Cancer
Product: DOCETAXEL HOSPIRA 10 mg/mL, solution à diluer pour perfusion, OXALIPLATINE SUN 5 mg/ml, solution à diluer pour perfusion, FOLINATE DE CALCIUM EBEWE 10 mg/ml, solution injectable/pour perfusion, PDR001, FLUOROURACILE ACCORD 50 mg/ml, solution à diluer pour perfusion

Primary endpoint: The primary endpoint is the proportion of patients with pCR in the primary tumour defined as: no tumour residue found in the tissue collected during the surgery evaluated by the pathologist
Endpoint(s): - Disease-free survival (DFS) defined as time between inclusion and first progression according to RECIST v1.1 criteria or death whatever cause (in the absence of progression); patients without disease progression or death at the time of analysis will be censored at the time of the latest date of assessment, - Overall survival (OS) defined as the time between inclusion and death whatever cause; any patient not known to have died at the time of analysis will be censored based on the last recorded date on which the patient was known to be alive, - Proportion of patients with margin-free resection (R0), defined as a microscopically margin-negative resection, in which no gross or microscopic tumor remains in the primary tumor bed, - Correlation between pCR and DFS, - Correlation between pCR and OS, - Toxicities of the combination Spartalizumab + FLOT regimen according to NCI CTCAE criteria v5.0, - Post-operative morbidity, defined post-operative complications grades II-V according to Clavien-Dindo classification during surgery, within 30 days after surgery or during the hospital stay, - Post-operative mortality, defined as the rate of patients died due to any cause during the 30 days post-surgery

Source: https://euclinicaltrials.eu/ctis-public/view/2024-516299-13-00